EU clinical trial 2023-510097-14-00: Randomized phase III trial in MMR deficient endometrial cancer patients comparing chemotherapy alone versus Dostarlimab in first line advanced/metastatic setting: DOMENICA STUDY (GINECO-EN105b/ENGOT-en13 study)
Protocol code: GINECO-EN105b
Sponsor: Arcagy Gineco (Laboratory/Research/Testing facility). Phase: Therapeutic confirmatory (Phase III). Countries: France (ongoing, recruitment ended), Spain (ongoing, recruitment ended), Italy (ongoing, recruitment ended), Romania (authorised, recruitment pending).
Therapeutic area(s): Diseases [C] - Neoplasms [C04]
Gender: Female. Age: 18-64 years. Enrolment: 217.
Start date (EU): 2022-04-15. Decision date: 2024-02-23. Results received: No. Last updated: 2025-12-18.
Decision dates by country: IT: 2024-02-26, RO: 2025-02-24, FR: 2024-03-08, ES: 2024-02-23

Condition(s): Patients with MMR deficient relapse or advanced / metastatic endometrial cancer
Product: CARBOPLATIN, PACLITAXEL, DOSTARLIMAB

Primary endpoint: Progression Free Survival (PFS) assessed per BICR (Blinded Independent Central Review)
Endpoint(s): Overall survival (OS), Progression Free Survival 2 (PFS2), Quality of Life (QoL), Best objective Response Rate (ORR), Disease control rate (DCR), Duration of Response Rate (DoR), PFS, DoR as per investigator assessment, Safety and tolerability, Time to first and second Subsequent Treatment, Efficacy of second systemic therapies, To describe the pharmacokinetics of dostarlimab, To determine the immunogenicity of dostarlimab

Source: https://euclinicaltrials.eu/ctis-public/view/2023-510097-14-00